EU clinical trial 2024-519747-15-00: A phase III open label study controlled by vitamin D3 supplementation and the differences between young adults and senior population
Protocol code: D3-2024
Sponsor: Fakultni Nemocnice Plzen (Hospital/Clinic/Other health care facility). Phase: Therapeutic confirmatory (Phase III). Countries: Czechia (ongoing, recruiting).
Therapeutic area(s): Diseases [C] - Immune System Diseases [C20]
Gender: Female, Male. Age: 18-64 years, 65+ years. Enrolment: 150.
Status: Ongoing, recruiting. Start date (EU): 2025-09-15. Decision date: 2025-03-05. Results received: No. Last updated: 2025-09-16.

Condition(s): Healthy population
Product: Vigantol 0,5 mg/ml perorální kapky, roztok

Primary endpoint: Primary end point is Serum 25 hydroxycholecalciferol.
Endpoint(s): Secondary end points are Serum 24,25-dihydroxycholecalciferol levels and Serum 3-epi-25-hydroxycholecalciferol levels.

Source: https://euclinicaltrials.eu/ctis-public/view/2024-519747-15-00